EU clinical trial 2024-514148-99-00: Markers of bonestatus in Diabetes Mellitus patients (type 1 and type 2) and the effect of antiresorptive treatment on glycemic markers
Sponsor: Aalborg University Hospital (Hospital/Clinic/Other health care facility). Phase: Therapeutic use (Phase IV). Countries: Denmark (ended).
Therapeutic area(s): Diseases [C] - Nutritional and Metabolic Diseases [C18]
Gender: Female, Male. Age: 18-64 years, 65+ years. Enrolment: 64.
Status: Ended. Start date (EU): 2013-08-15. End date (EU): 2026-03-24. Decision date: 2024-06-26. Results received: No. Last updated: 2024-06-26.

Condition(s): Diabetes Mellitus and Osteopenia/Osteoporosis
Product: Alendronat Teva 70 mg tabletter, Placebo 8 mm with scoreline

Primary endpoint: HbA1c and BMD
Endpoint(s): Insulin, plasmaglucose, HOMA-IR, hs-CRP, AGE markers, lipids, adiponectin, PTH, 25 og 1,25 vitamin D, bone specific alkaline phosphatase, FSH, LH, testestoron/østradiol, creatinine, GFR, FGF23, sclerostin, osteocalcin, ucOC, P1NP, PICP, CTX, osteoprotegrin, RANKL and pentosidine. Urine albumin/creatinine ratio and urine bone markers. HRpQCT scan results. Analysis results by fat tissue-, muscle tissue- and bone biopsies. Life style questionnaire including diet and physical activity.

Source: https://euclinicaltrials.eu/ctis-public/view/2024-514148-99-00